EU clinical trial 2023-503653-35-00: Clindamycin pharmacokinetics during obstetric or fetal surgery
Protocol code: S-67465
Sponsor: UZ Leuven (Hospital/Clinic/Other health care facility). Phase: Therapeutic use (Phase IV). Countries: Belgium (ended).
Therapeutic area(s): Diseases [C] - Female Urogenital Diseases and Pregnancy Complications [C13]; Diseases [C] - Bacterial Infections and Mycoses [C01]
Gender: Female. Age: 18-64 years. Enrolment: 0.
Status: Ended. Start date (EU): 2023-12-11. End date (EU): 2024-12-17. Decision date: 2023-08-30. Results received: Yes. Last updated: 2023-09-25.

Condition(s): Prophylaxis (antibiotics) during maternal or fetal surgery
Product: Dalacin C 600 mg solution injectable

Primary endpoint: A population pharmacokinetic analysis approach will be performed, comparing the data on PK already reported in adults or other pregnant women and the newly collected data during pregnancy. The quality of fit of the pharmacokinetic model to the data will be sought by NONMEM's objective function and by visual examination of plots of observed vs predicted concentrations. Clindamycin concentrations in maternal plasma and amniotic fluid will be measured at the different sample collection timepoints.
Endpoint(s): Pharmacokinetic analysis, including the covariates of interest or relevant clinical characteristics i.e., body weight, length, age, body surface area (BSA), gestational age, type of delivery, intercurrent co-morbidity (e.g., renal and hepatic dysfunction, hypothermia, hypothyroidism), other parenteral or other co-medications.

Source: https://euclinicaltrials.eu/ctis-public/view/2023-503653-35-00